EU clinical trial 2024-517948-66-00: A phase IIb, randomized, double-blind, multicenter study evaluating the efficacy of botulinum toxin versus placebo on pain and health related quality of life of patients with piriformis muscle syndrome
Protocol code: PHRCN/2019/AD-01
Sponsor: Centre Hospitalier Universitaire De Nimes (Hospital/Clinic/Other health care facility). Phase: Therapeutic exploratory (Phase II). Countries: France (authorised, recruitment pending).
Therapeutic area(s): Diseases [C] - Musculoskeletal Diseases [C05]
Gender: Female, Male. Age: 18-64 years, 65+ years. Enrolment: 108.
Status: Authorised, recruitment pending. Decision date: 2025-08-14. Results received: No. Last updated: 2025-10-21.

Condition(s): Piriformis muscle syndrome
Product: XEOMIN 200 units powder for solution for injection, Le placebo est composé des seuls excipients présents dans le XEOMIN, à savoir 4.7 mg de sucrose + 1mg de sérum-albumine humaine par ampoule de poudre pour injection.

Primary endpoint: The change in sciatic pain intensity, from baseline, at 6 weeks after injection. The sciatic pain will be measured by VAS (100mm scale). The patient will answer the following question: “What was the average intensity of your pain over the last 24 hours?”.
Endpoint(s): Change in buttock pain intensity (assessed on Visual Analog Scale value, 0 = no pain, 10 = worst pain), from baseline, at 6 weeks after injection., Variations from baseline in Health-related quality of life (HRQoL) (EQ-5D) at 6 weeks after injection as well as over a period of 6 months. HRQoL will be assessed at each visit (at inclusion and at 6, 12, 18 and 24 weeks of follow-up after injection)., Variations from baseline, over the 6-month follow-up, in sciatic pain intensity (VAS value), in buttock pain intensity (on VAS), in quality of life (HRQoL, EQ-5D) at 6 weeks after injection as well as over a period of 6 months, in physical functioning (BPI and PGI-I), in anxiety and depression (HADS) over 6 months in disability (ODI), in the tolerance of the sitting position assessed at each visit, consumption of painkillers., Number of patients requiring a second injection (botulinum toxin) at 12 weeks in each arm., Side effects of treatment during follow-up in each arm.

Source: https://euclinicaltrials.eu/ctis-public/view/2024-517948-66-00